EU clinical trial 2024-513568-24-00: A Randomized, Double-Blind, Parallel Group, Multicenter 24 Week Study to Assess the Efficacy and Safety of Budesonide and Formoterol Fumarate Metered Dose Inhaler Relative to Budesonide Metered Dose Inhaler and Open-Label Symbicort® Turbuhaler® in Participants with Inadequately Controlled Asthma (VATHOS)
Protocol code: D5982C00006
Sponsor: AstraZeneca AB (Pharmaceutical company). Phase: Therapeutic confirmatory (Phase III). Countries: Spain (ended), Italy (ended), Germany (ended).
Therapeutic area(s): Diseases [C] - Respiratory Tract Diseases [C08]
Gender: Female, Male. Age: 0-17 years, 18-64 years, 65+ years. Enrolment: 160.
Status: Ended. Start date (EU): 2022-03-23. End date (EU): 2025-02-12. End date: 2025-02-26. Decision date: 2024-06-12. Results received: Yes. Last updated: 2025-02-20.
Decision dates by country: ES: 2024-06-12, IT: 2024-06-18, DE: 2024-06-18

Condition(s): Inadequately Controlled Asthma
Product: Symbicort, 160 mikrogram/4,5 mikrogram/puff inhalationsspray, suspension, BFF (PT009), BD ( PT008), SALBUTAMOL, Placebo MDI and empty TBH devices (only for training purposes)

Primary endpoint: 1. Change from baseline in morning pre-dose trough FEV1 over 24 weeks.
Endpoint(s): 1.Change from baseline in FEV1 AUC0-3 over 24 Weeks., 2.Change from baseline in the mean number of puffs of rescue medication use (puffs/day) over 24 Weeks., 3.Percentage of responders in ACQ-7 (≥ 0.5 decrease equals response) over 24 Weeks., 4.Percentage of responders in ACQ-5 (≥ 0.5 decrease equals response) over 24 Weeks., 5.Percentage of responders in the AQLQ(s)+12 (≥ 0.5 increase equals response) over 24 Weeks., 6.Percentage of responders in AQLQ(s)+12 (≥ 0.5 increase equals response) over 12 to 24 weeks., 7.Onset of action on Day 1: Absolute change in FEV1 at 5 minutes post dose on Day 1.

Source: https://euclinicaltrials.eu/ctis-public/view/2024-513568-24-00